EU clinical trial 2024-516368-27-00: Double-blind placebo-controlled clinical trial (Phase 1b/2a) to evaluate safety and efficacy of IM-250 administration in patients with recurrent genital herpes.
Protocol code: IM-202
Sponsor: Innovative Molecules GmbH (Pharmaceutical company). Phase: Phase I and Phase II (Integrated)- Other. Countries: Bulgaria (ongoing, recruiting), Estonia (authorised, recruitment pending).
Therapeutic area(s): Diseases [C] - Skin and Connective Tissue Diseases [C17]; Diseases [C] - Virus Diseases [C02]
Gender: Female, Male. Age: 18-64 years. Enrolment: 232.
Start date (EU): 2025-01-16. Decision date: 2024-12-18. Results received: No. Last updated: 2026-08-06.
Decision dates by country: EE: 2026-08-04, BG: 2024-12-18

Condition(s): Genital herpes infection
Product: IM-250 Placebo, IM-250 50mg Capsules

Primary endpoint: • Rate of HSV shedding, defined as number of days on which genital swab HSV PCR test was positive divided by the total number of days on which genital swabs were obtained in patients receiving different dosing regimens of IM-250 or placebo.
Endpoint(s): • Rate of genital lesions, defined as number of days with genital lesions during the 28-day period starting from Day 1 (Phase 1b) or Day 8 (Phase 2a) after the first administration of IM-250 or placebo, divided by 28, in patients receiving different dosing regimens of IM-250 or placebo., • Rate of genital lesions, defined as number of days with genital lesions during the 56-day period starting from Day 1 (Phase 1b) and during 63-day period starting from Day 8 (Phase 2a) after the first administration of IM-250 or placebo, divided by 56 and 63, respectively, in patients receiving different dosing regimens of IM-250 or placebo., • HSV quantity, defined as log10 HSV DNA copies on days that shedding is detected in patients receiving different dosing regimens of IM-250 or placebo., • The rate of subclinical shedding, defined as number of days on which genital swab HSV PCR test was positive in absence of a genital lesion divided by the total number of days without lesions on which genital swabs were obtained in patients receiving different dosing regimens of IM-250 or placebo., Determining the exposure by different doses of IM-250 after single dose (Day 1) as defined by: • the area under the curve from 0 to infinity (AUC0-ꚙ), •maximum observed concentration after single dose (Cmax), •plasma concentration at 24 hours (C24h) and 8 d (C8d), •the area under the curve from 0 to 24 hours (AUC0-24), •the area under the curve from 0 to 168 hours (AUC0-168), •time to reach Cmax (tmax), •half-life (t1/2), •apparent clearance (CL / F), •mean residence time (MRT), •volume of dist, • HSV quantity, defined as log10 HSV DNA copies on days that shedding is detected, and genital lesion is detected in patients receiving different dosing regimens of IM-250 or placebo., Determining the exposure by different doses of IM-250 after multiple doses (Day 22) as defined by: • the area under the curve from 0 to infinity (AUC0-ꚙ,ss), • maximum observed concentration at steady state (Cmax,ss), • plasma concentration at 24 hours (C24h,ss) and 8 d (C8d,ss), • the area under the curve from 0 to 24 hours (AUC0-24,ss), • the area under the curve from 0 to 168 hours (AUC0-168,ss), • time to reach Cmax,ss (tmax,ss)., Determining the exposure by different dosing regimens of IM-250 after multiple doses (Day 36) as defined by: •the area under the curve from study medication administration to 24 hours post dose at steady state (AUC0-24,ss), •the area under the curve from study drug administration extrapolated to infinity at steady state (AUC0-ꚙ,ss), •maximum observed concentration at steady state (Cmax ,ss), • minimum observed concentration at steady state (Cmin,ss), •apparent clearance at steady state (Cmin,ss

Source: https://euclinicaltrials.eu/ctis-public/view/2024-516368-27-00